EU clinical trial 2022-502685-25-00: Primary chemoradiation versus neoadjuvant chemotherapy followed by surgery as treatment strategy for locally advanced vulvar carcinoma (VULCANize2)
Sponsor: Stichting Het Nederlands Kanker Instituut-Antoni Van Leeuwenhoek Ziekenhuis (Hospital/Clinic/Other health care facility). Phase: Phase II and Phase III (Integrated). Countries: Netherlands (ongoing, recruiting), Belgium (authorised, recruiting), Czechia (authorised, recruiting), Spain (authorised, recruitment pending).
Therapeutic area(s): Diseases [C] - Neoplasms [C04]
Gender: Female. Age: 18-64 years, 65+ years. Enrolment: 98.
Start date (EU): 2024-01-01. Decision date: 2023-08-10. Results received: No. Last updated: 2026-06-02.
Decision dates by country: NL: 2023-08-10, BE: 2025-04-11, ES: 2025-06-16, CZ: 2025-04-23

Condition(s): The trial population will consist of patients with LAVC who require primary chemoradiation or extensive surgery damaging pelvic organs or exenterative surgery.
Product: CARBOPLATIN, PACLITAXEL, CISPLATIN

Primary endpoint: The primary endpoint is loco‐regional control at 2 years per arm, including salvage or adjuvant treatments
Endpoint(s): Morbidity, Disease-related treatment failure, Disease-free survival, Prevention of trimodal treatment (surgery and chemotherapy and radiotherapy), functional organ preservation, Quality of life, Treatment-related morbidity, death, Complications, Influence of HPV status on treatment outcome

Source: https://euclinicaltrials.eu/ctis-public/view/2022-502685-25-00